EU clinical trial 2023-505735-13-01: A Phase 1b/2a Study to Evaluate the Safety, Pharmacokinetics and Efficacy of IMG-007 in Adult Participants with Moderate-to-Severe Atopic Dermatitis
Protocol code: IMG-007-201
Sponsor: Inmagene LLC (Pharmaceutical company). Phase: Phase I and Phase II (Integrated)- Other. Countries: Germany (ended), Poland (ended).
Therapeutic area(s): Diseases [C] - Immune System Diseases [C20]
Gender: Female, Male. Age: 18-64 years, 65+ years. Enrolment: 40.
Status: Ended. End date (EU): 2024-04-26. End date: 2024-04-27. Decision date: 2024-03-19. Results received: Yes. Last updated: 2024-03-25.
Decision dates by country: DE: 2024-03-19, PL: 2024-03-25

Condition(s): Atopic dermatitis
Product: IMG-007 placebo is identical in formulation to that of the drug product minus the active ingredient., IMG-007

Primary endpoint: Incidence of TEAEs
Endpoint(s): PK parameters as data permit, Percentage change in EASI from Baseline to Week 12

Source: https://euclinicaltrials.eu/ctis-public/view/2023-505735-13-01